EU clinical trial 2024-518723-30-01: Blockade of the renin-angiotensin system in kidney transplant patients with the presence of renal progenitor cells in urine: randomized clinical trial.
Protocol code: PRONE
Sponsor: Bellvitge University Hospital (Hospital/Clinic/Other health care facility). Phase: Therapeutic use (Phase IV). Countries: Spain (ongoing, recruitment ended).
Therapeutic area(s): Not possible to specify; Diseases [C] - Pathological Conditions, Signs and Symptoms [C23]
Gender: Female, Male. Age: 18-64 years, 65+ years. Enrolment: 180.
Status: Ongoing, recruitment ended. Start date (EU): 2024-10-16. Decision date: 2024-10-16. Results received: No. Last updated: 2024-10-16.

Condition(s): Renal transplant patients
Product: Valsartan STADA 80 mg Filmtabletten

Primary endpoint: No primary endpoint
Endpoint(s): No secondary endpoint

Source: https://euclinicaltrials.eu/ctis-public/view/2024-518723-30-01